EU clinical trial 2023-508701-24-00: A Phase III, Randomized, Open-Label, Sponsor-Blinded, Multicenter Study of Durvalumab in Combination with Tremelimumab ± Lenvatinib Given Concurrently with Transarterial Chemoembolization (TACE) Compared to TACE Alone in Patients with Locoregional Hepatocellular Carcinoma (EMERALD-3)
Protocol code: D910VC00001
Sponsor: AstraZeneca AB (Pharmaceutical company). Phase: Therapeutic confirmatory (Phase III). Countries: Germany (ongoing, recruitment ended), Portugal (ongoing, recruitment ended), Belgium (ongoing, recruitment ended), France (ongoing, recruitment ended), Spain (ongoing, recruitment ended), Italy (ongoing, recruitment ended).
Therapeutic area(s): Diseases [C] - Neoplasms [C04]
Gender: Female, Male. Age: 18-64 years, 65+ years. Enrolment: 131.
Status: Ongoing, recruitment ended. Start date (EU): 2022-11-21. Decision date: 2024-04-19. Results received: No. Last updated: 2026-08-07.
Decision dates by country: BE: 2024-04-26, DE: 2024-04-22, IT: 2024-05-13, FR: 2024-04-26, PT: 2024-04-22, ES: 2024-04-19

Condition(s): Locoregional Hepatocellular Carcinoma (HCC)
Product: MYCOPHENOLATE MOFETIL, LENVIMA 4 mg hard capsules, INFLIXIMAB, IMJUDO 20 mg/ml concentrate for solution for infusion., IMFINZI 50 mg/mL concentrate for solution for infusion.

Primary endpoint: Progression Free Survival (PFS) per RECIST 1.1 as assessed by BICR
Endpoint(s): Overall Survival (OS)

Source: https://euclinicaltrials.eu/ctis-public/view/2023-508701-24-00